EU clinical trial 2023-510294-34-00: A phase 3 multicenter, randomised, prospective, open-label trial of fixed-duration (12 cycles) venetoclax/ obinutuzumab vs. fixed-duration (15 cycles) venetoclax/ pirtobrutinib vs. MRD-guided venetoclax/ pirtobrutinib in patients with previously untreated chronic lymphocytic leukaemia (CLL)/ small lymphocytic lymphoma (SLL) aiming to establish measurement of individual residual disease for adjustment of treatment duration to improve outcomes (CLL18/MOIRAI)
Protocol code: CLL18/MOIRAI
Sponsor: University Of Cologne (Educational Institution). Phase: Therapeutic confirmatory (Phase III). Countries: Sweden (ongoing, recruiting), Germany (ongoing, recruiting), Denmark (ongoing, recruiting), Poland (ongoing, recruiting), Norway (ongoing, recruiting), Finland (ongoing, recruiting), Czechia (ongoing, recruiting), France (ongoing, recruiting), Spain (ongoing, recruiting), Netherlands (ongoing, recruiting), Austria (ongoing, recruiting), Belgium (ongoing, recruiting), Ireland (ongoing, recruiting), Italy (ongoing, recruiting).
Therapeutic area(s): Diseases [C] - Neoplasms [C04]
Gender: Female, Male. Age: 18-64 years, 65+ years. Enrolment: 746.
Status: Ongoing, recruiting. Start date (EU): 2025-06-12. Decision date: 2025-03-27. Results received: No. Last updated: 2026-07-29.
Decision dates by country: IE: 2025-04-04, CZ: 2025-04-01, AT: 2025-04-06, BE: 2025-03-27, DE: 2025-03-28, NO: 2025-03-27, NL: 2025-04-03, FI: 2025-03-27, PL: 2025-04-06, DK: 2025-04-01, ES: 2025-03-28, FR: 2025-03-31, SE: 2025-03-27, IT: 2025-08-04

Condition(s): small lymphocytic lymphoma (SLL), chronic lymphocytic leukemia (CLL)
Product: Venetoclax, Venetoclax, Venetoclax, PIRTOBRUTINIB, Gazyvaro 1,000 mg concentrate for solution for infusion.

Primary endpoint: Progression-free survival (PFS)
Endpoint(s): Measurable residual disease (MRD) levels by different types of measurement from different materials at final restaging (performed 3 months after end of treatment in all patients - except for patients that show progression of CLL disease or Richter transformation before this point of time - which differs depending on the duration of treatment) and selected other time points during and after treatment, Overall response rate (ORR) and complete response (CR) rate at the final restaging and selected other time points, Duration of response (DOR), Time to next treatment (TTNT), Treatment-free survival (TFS), Overall survival (OS), Safety parameters: Type, frequency and severity of - adverse events (AEs) - adverse events of particular interest (AEPI), Best response assessed until 1 year after end of treatment

Source: https://euclinicaltrials.eu/ctis-public/view/2023-510294-34-00